EU clinical trial 2023-503265-27-00: A Phase 3, Open-Label, Randomized Study of Perioperative Dostarlimab Monotherapy versus Standard of Care in Participants with Untreated T4N0 or Stage III dMMR/MSI-H Resectable Colon Cancer
Protocol code: 219606
Sponsor: Glaxosmithkline Research & Development Limited (Pharmaceutical company). Phase: Therapeutic confirmatory (Phase III). Countries: Norway (ongoing, recruitment ended), France (ongoing, recruitment ended), Italy (ongoing, recruitment ended), Spain (ongoing, recruitment ended), Greece (ended), Belgium (ongoing, recruitment ended), Netherlands (ongoing, recruitment ended), Germany (ongoing, recruitment ended), Finland (ongoing, recruitment ended), Sweden (ongoing, recruitment ended), Estonia (ongoing, recruitment ended), Portugal (ongoing, recruitment ended), Czechia (authorised, recruiting), Poland (ongoing, recruitment ended).
Therapeutic area(s): Diseases [C] - Neoplasms [C04]
Gender: Female, Male. Age: 18-64 years, 65+ years. Enrolment: 543.
Start date (EU): 2023-11-23. Decision date: 2023-09-18. Results received: No. Last updated: 2026-06-01.
Decision dates by country: GR: 2023-09-19, ES: 2023-09-25, PL: 2025-06-08, FI: 2023-09-19, NO: 2023-09-25, PT: 2024-06-11, IT: 2023-09-21, EE: 2024-05-09, BE: 2023-09-18, CZ: 2025-06-09, NL: 2023-09-18, FR: 2023-09-19, SE: 2023-09-22, DE: 2023-09-25

Condition(s): Participants with Untreated T4N0 or Stage III dMMR/MSI-H Resectable Colon Cancer
Product: JEMPERLI 500 mg concentrate for solution for infusion, Xeloda 500 mg film-coated tablets, Oxaliplatin 5mg/ml Concentrate for Solution for Infusion, Oxaliplatin 5mg/ml Concentrate for Solution for Infusion, Xeloda 150 mg film-coated tablets, Leucovorin-Teva 10 mg/ml Concentrate for Solution for Infusion, Fluorouracil 25 mg/ml Solution for Injection or Infusion, Oxaliplatin 5mg/ml Concentrate for Solution for Infusion

Primary endpoint: Event Free Survival (EFS) with recurrence assessed by Blinded Independent Central Review (BICR). Where an event is defined as: Disease recurrence based on radiological assessment by BICR; Disease progression precluding surgery (local assessment); Disease recurrence based on a pathological assessment of new lesions identified after surgery (local assessment); Death due to any cause; Treatment related toxicity that results in the participant not being suitable for surgery.
Endpoint(s): Pathological response determined by local assessment., OS, defined as time from randomization to death from any cause., EFS with recurrence assessed by local assesment (component events are the same as primary endpoint)., Frequency and severity of treatment emergent AEs, SAEs, irAEs, and AEs leading to death or discontinuation of study intervention., Serum concentrations and relevant PK parameters (C-EoI and Ctrough) for dostarlimab., Incidence of ADA against dostarlimab.

Source: https://euclinicaltrials.eu/ctis-public/view/2023-503265-27-00